EU clinical trial 2024-513581-19-00: Inhibition of Mast cell Activation in AtheroScleroTic lesions using an Anti-IgE antibody approach (MAST)
Protocol code: 19-659
Sponsor: Universitair Medisch Centrum Utrecht (Hospital/Clinic/Other health care facility). Phase: Phase III and phase IV (Integrated). Countries: Netherlands (ended).
Therapeutic area(s): Diseases [C] - Cardiovascular Diseases [C14]
Gender: Female, Male. Age: 18-64 years, 65+ years. Enrolment: 40.
Status: Ended. End date (EU): 2024-11-14. Decision date: 2024-08-01. Results received: Yes. Last updated: 2024-08-01.

Condition(s): Carotid artery stenosis
Product: Xolair 150 mg solution for injection in pre-filled syringe, Physiological saline

Primary endpoint: Primary study endpoint is the % of mast cell activation, which can be measured with flow cytometry.
Endpoint(s): The effect of omalizumab on the level of inflammation of patients with atherosclerosis by measuring the percentage of inflammatory cells (T cell subsets, M1/M2 macrophages, neutrophils, B-cells) in the immune cell suspension obtained from the plaque using flow cytometry., The effect of omalizumab treatment on circulating IgE levels determined by ELISA., The effect of omalizumab on tryptase levels (and thereby on systemic mast cell activation)., The effect of omalizumab on plaque levels of tryptase and chymase., The effect of omalizumab on the activation status of basophils by using a BAT assay., The effect of omalizumab on plaque phenotype such as necrotic area, cellular composition and stability parameters using histology., The effect of omalizumab on circulating white blood cell count, hsCRP, IL-1B and IL-6., As a secondary safety parameter the occurence of arterial thromboembolic events will be documented.

Source: https://euclinicaltrials.eu/ctis-public/view/2024-513581-19-00